EU clinical trial 2023-509998-23-00: A Phase I/II, Multicenter, Non-randomized, Open Label, Adaptive Design, 5-year Follow-up, Single Dose-escalation Study of VTX-801 in Adult Patients with Wilson's Disease
Protocol code: VTX-801_CLN_001
Sponsor: Vivet Therapeutics (Pharmaceutical company). Phase: Phase I and Phase II (Integrated)- First administration to humans. Countries: Germany (ended), Denmark (ended).
Therapeutic area(s): Diseases [C] - Nutritional and Metabolic Diseases [C18]
Gender: Female, Male. Age: 18-64 years. Enrolment: 7.
Status: Ended. Start date (EU): 2022-06-21. End date (EU): 2024-10-08. Decision date: 2024-04-18. Results received: Yes. Last updated: 2024-04-19.
Decision dates by country: DK: 2024-04-18, DE: 2024-04-19

Condition(s): Wilson's Disease

Primary endpoint: Safety and tolerability profile, including treatment-emergent adverse events (TEAE), clinical examination, changes in laboratory parameters, vital signs, ECG, brain and abdominal MRI
Endpoint(s): Free serum Cu, Total serum Cu, 24-hour urinary Cu, Serum ceruloplasmin activity (enzymatic assay), VTX-801 Responder status, Immune response to VTX-801

Source: https://euclinicaltrials.eu/ctis-public/view/2023-509998-23-00